EU clinical trial 2023-507539-40-00: A Phase 2b, Randomised, Double-Blind, Placebo-Controlled Study to Evaluate the Efficacy, Safety, and Tolerability of 3 Dose Levels of NMD670 over 21 Days in Adult Patients with AChR/MuSK-Ab+ Myasthenia Gravis
Protocol code: NMD670-02-0002
Sponsor: NMD Pharma A/S (Pharmaceutical company). Phase: Therapeutic exploratory (Phase II). Countries: Denmark (ongoing, recruiting), Spain (authorised, recruiting), Poland (ongoing, recruiting), Netherlands (ongoing, recruiting), Italy (ongoing, recruiting), France (ongoing, recruiting), Belgium (ended).
Therapeutic area(s): Diseases [C] - Nervous System Diseases [C10]
Gender: Female, Male. Age: 18-64 years, 65+ years. Enrolment: 59.
Start date (EU): 2024-07-19. Decision date: 2024-06-17. Results received: No. Last updated: 2026-02-26.
Decision dates by country: ES: 2024-06-17, FR: 2024-06-20, BE: 2024-06-19, PL: 2024-06-24, NL: 2024-06-20, IT: 2024-06-20, DK: 2024-06-17

Condition(s): Myasthenia Gravis
Product: NMD670, NMD670, Placebo

Primary endpoint: Change from baseline to day 21 in quantitative myasthenia gravis (QMG) total score for NMD670 vs placebo

Source: https://euclinicaltrials.eu/ctis-public/view/2023-507539-40-00